EU clinical trial 2024-516347-41-00: PAXIS: A randomized, double-blind, placebo-controlled dose-finding phase 2 study (Part 1) followed by an open-label period (Part 2) to assess the efficacy and safety of pacritinib in patients with VEXAS syndrome
Protocol code: PAC601
Sponsor: Sobi Inc. (Pharmaceutical company). Phase: Therapeutic exploratory (Phase II). Countries: Spain (ongoing, recruitment ended), France (ongoing, recruitment ended), Italy (ongoing, recruitment ended), Germany (ongoing, recruitment ended).
Therapeutic area(s): Diseases [C] - Immune System Diseases [C20]
Gender: Female, Male. Age: 18-64 years, 65+ years. Enrolment: 36.
Status: Ongoing, recruitment ended. Start date (EU): 2025-04-29. Decision date: 2025-04-07. Results received: No. Last updated: 2026-07-06.
Decision dates by country: ES: 2025-04-08, FR: 2025-04-07, DE: 2025-04-11, IT: 2025-04-11

Condition(s): VEXAS Syndrome
Product: Pacritinib, placebo to match pacritinib oral capsules

Primary endpoint: 1. The primary endpoint is Overall Clinical Response (OCR), defined as achieving Clinical Response or better at any time during the double-blind treatment period.
Endpoint(s): 1. Best Response (Clinical Biochemical Response, Clinical Response, Partial Clinical Response, Stable Disease, or Non-response) during the double-blind treatment period. Note that Stringent Clinical Biochemical Response is not applicable during the double-blind treatment period (i.e., by Week 24) based on the fixed GC taper schedule, 2. Number of flare-free days with GC dose <10 mg during the double-blind treatment period., 3. Hematologic Improvement – Erythroid (HI-E) at any time during the double-blind treatment period among participants with baseline hemoglobin <10 g/dL, per modified International Working Group (IWG) criteria., 4. Hematologic Improvement – Platelets (HI-P) at any time during the double-blind treatment period among participants with baseline platelet count <100 × 10^9/L, per modified IWG criteria., 5. Change in health-related QOL as measured by Patient-Reported Outcomes Measurement Information System (PROMIS) short forms (fatigue, physical function, sleep disturbance), 36-Item Short Form Health Survey (SF-36), and the Patient Global Impression of Change (PGIC)., 6. PK of pacritinib., 7. PD inflammatory biomarkers (CRP, erythrocyte sedimentation rate [ESR][where available], ferritin), 8. Safety and tolerability, assessed by adverse events (AEs), laboratory tests, electrocardiogram (ECG) results, and vital signs will be assessed throughout the double-blind and open-label treatment periods.

Source: https://euclinicaltrials.eu/ctis-public/view/2024-516347-41-00